EU clinical trial 2024-514354-67-00: A Phase 3, multicenter, open-label, single-arm, extension study to evaluate the long-term safety and tolerability of cenerimod in adult subjects with moderate-to-severe systemic lupus erythematosus (SLE) on top of background therapy (OPUS OLE)
Protocol code: ID-064A303
Sponsor: Viatris Innovation GmbH (Pharmaceutical company). Phase: Therapeutic confirmatory (Phase III). Countries: France (ongoing, recruiting), Portugal (ongoing, recruiting), Poland (ongoing, recruiting), Germany (ongoing, recruiting), Spain (ongoing, recruiting), Czechia (ongoing, recruiting), Greece (ongoing, recruiting), Bulgaria (ongoing, recruiting), Romania (ongoing, recruiting).
Therapeutic area(s): Diseases [C] - Immune System Diseases [C20]
Gender: Female, Male. Age: 18-64 years, 65+ years. Enrolment: 172.
Status: Ongoing, recruiting. Start date (EU): 2024-11-01. Decision date: 2024-09-20. Results received: No. Last updated: 2026-06-15.
Decision dates by country: CZ: 2024-09-23, FR: 2024-09-20, DE: 2024-09-20, PT: 2024-09-25, RO: 2024-09-30, PL: 2024-09-30, GR: 2024-09-25, BG: 2024-09-30, ES: 2024-09-23

Condition(s): Systemic lupus erythematosus
Product: Cenerimod 4 mg

Primary endpoint: Occurrence of treatment-emergent adverse events up to the final study visit., Occurrence of serious adverse events up to the final study visit., Occurrence of adverse events of special interest (i.e., anticipated risks of treatment with cenerimod, known class effects, and events that may be related to systemic lupus erythematosus comorbidities) up to the final study visit.

Source: https://euclinicaltrials.eu/ctis-public/view/2024-514354-67-00